EU clinical trial 2024-517992-19-00: A Clinical Trial to Test the Safety, Tolerability, and How the Body Processes CPV-104 in Healthy People and Patients with C3-Glomerulopathy
Protocol code: CPV-104-101
Sponsor: Eleva GmbH (Pharmaceutical company). Phase: Human Pharmacology (Phase I)- First administration to humans. Countries: Austria (ongoing, recruiting), Greece (ongoing, recruiting), Spain (ongoing, recruiting), Czechia (authorised, recruiting), Latvia (authorised, recruiting), Belgium (ongoing, recruiting), France (ongoing, recruiting), Netherlands (ongoing, recruiting), Portugal (ongoing, recruiting), Sweden (ongoing, recruiting), Lithuania (ongoing, recruiting).
Therapeutic area(s): Diseases [C] - Immune System Diseases [C20]
Gender: Female, Male. Age: 18-64 years, 65+ years. Enrolment: 58.
Start date (EU): 2025-06-11. Decision date: 2025-06-02. Results received: No. Last updated: 2026-06-01.
Decision dates by country: FR: 2025-09-12, LV: 2025-08-26, SE: 2025-08-25, CZ: 2025-08-27, NL: 2025-09-08, BE: 2025-09-04, AT: 2025-06-02, GR: 2025-09-01, PT: 2025-09-12, LT: 2025-09-08, ES: 2025-08-27

Condition(s): C3 glomerulopathy (C3G)

Source: https://euclinicaltrials.eu/ctis-public/view/2024-517992-19-00